EU clinical trial 2024-516532-97-00: A Phase 1/2, Open-Label, Multi-Center Trial to Assess Safety, Tolerability, Pharmacokinetics, Pharmacodynamics, and Efficacy of CLN-081 in Patients with Locally-Advanced or Metastatic Non-Small Cell Lung Cancer Harboring EGFR Exon 20 Insertion Mutations Who Have Previously Received Platinum-Based Systemic Chemotherapy
Protocol code: CLN-081-001
Sponsor: Cullinan Pearl Corp. (Pharmaceutical company). Phase: Phase I and Phase II (Integrated)- Other. Countries: Netherlands (ongoing, recruitment ended), Italy (ongoing, recruitment ended), Spain (ongoing, recruitment ended).
Therapeutic area(s): Diseases [C] - Neoplasms [C04]
Gender: Female, Male. Age: 18-64 years, 65+ years. Enrolment: 63.
Status: Ongoing, recruitment ended. Start date (EU): 2020-03-26. Decision date: 2024-09-23. Results received: No. Last updated: 2026-05-25.
Decision dates by country: IT: 2024-09-30, ES: 2024-10-10, NL: 2024-09-23

Condition(s): Non-Small Cell Lung Cancer Harboring EGFR Exon 20 Insertion Mutations
Product: CLN-081, CLN-081

Primary endpoint: 1. Phase 1: The rate and severity of treatment emergent AEs (TEAEs), SAEs, incidence of safety laboratory assessment abnormalities, 2. Phase 2a: ORR by investigator assessment per RECIST v1.1, 3. Module A: CLN-081 PK, 4. Module B, Part 1: *The rate and severity of TEAEs, DLTs, SAEs, incidence of safety laboratory assessment abnormalities; *CLN-081 PK, 5. Module B, Part 2 and 6. Module C: * ORR by independent central review assessment per RECIST v1.1; * Tumor response characteristics including DOR by independent central review
Endpoint(s): 1. Phase 1: a) ORR by Investigator assessment per RECIST v1.1 b) DOR, DCR, PFS, and OS by investigator assessment c) CLN-081 PK, 2. Phase 2a: a) DOR, DCR, PFS, time to tumor response, and OS based on investigator assessment b) The rate and severity of TEAEs, SAEs, incidence of safety laboratory assessment abnormalities c) CLN-081 PK, 3. Module A: a) The rate and severity of TEAEs, SAEs, incidence of safety laboratory assessment abnormalities, 4. Module B, Part 1: a) ORR based on independent central review assessment per RECIST v1.1 b) Tumor response characteristics including DOR, DCR, PFS, and time to tumor response based on local investigator assessment and OS, 5. Module B, Part 2: a) ORR and DOR by Investigator assessment b) DCR, median PFS, rate of PFS and OS at 6, 12 and 24 months based on independent central review and investigator assessment and OS c) The rate and severity of TEAEs, DLTs, SAEs, incidence of safety laboratory assessment abnormalities d) CLN-081 PK, 6. Module C: a) ORR and DOR by Investigator assessment per RECIST v1.1 b) Tumor response characteristics including DCR, PFS, and time to tumor response assessed by independent central review and investigator assessment and OS c) The rate and severity of TEAEs, DLTs, SAEs, incidence of safety laboratory assessment abnormalities d) CLN-081 PK

Source: https://euclinicaltrials.eu/ctis-public/view/2024-516532-97-00